EU clinical trial 2024-514479-16-00: A PHASE II, MULTICENTRE, OPEN-LABEL STUDY OF CABOZANTINIB AS 2ND LINE TREATMENT IN SUBJECTS WITH UNRESECTABLE, LOCALLY ADVANCED OR METASTATIC RENAL CELL CARCINOMA WITH A CLEAR-CELL COMPONENT WHO PROGRESSED AFTER 1ST LINE TREATMENT WITH CHECKPOINT INHIBITORS
Protocol code: F-FR-60000-023
Sponsor: Ipsen Pharma (Pharmaceutical company). Phase: Therapeutic exploratory (Phase II). Countries: Germany (ended), France (ended).
Therapeutic area(s): Diseases [C] - Neoplasms [C04]
Gender: Female, Male. Age: 18-64 years, 65+ years. Enrolment: 6.
Status: Ended. Start date (EU): 2019-10-28. End date (EU): 2026-02-12. Decision date: 2024-08-01. Results received: Yes. Last updated: 2025-10-07.
Decision dates by country: FR: 2024-08-01, DE: 2024-08-02

Condition(s): Unresectable, Locally Advanced or Metastatic Renal Cell Carcinoma with a Clear-Cell Component Who Progressed After 1st Line Treatment with Checkpoint Inhibitors
Product: CABOMETYX 60 mg film-coated tablets, CABOMETYX 40 mg film-coated tablets, CABOMETYX 20 mg film-coated tablets

Primary endpoint: Objective response rate (ORR) in cohort A per RECIST 1.1 evaluated by independent central review
Endpoint(s): Time to response (TTR) per RECIST 1.1 evaluated by independent central review, Duration of response (DOR) per RECIST 1.1 evaluated by independent central review, Disease control rate (DCR) per RECIST 1.1 by independent central review, Progression-free survival (PFS) per RECIST 1.1 by independent central review, ORR in cohort B defined as the proportion of subjects who achieved a partial response (PR) or complete response (CR) at any timepoint as determined by independent central review per RECIST 1.1, Overall survival (OS), ORR, TTR, DOR, DCR and PFS per RECIST 1.1 according to local Investigator's review, Change in disease-related symptoms as assessed by the Functional Assessment of Cancer Therapy-Kidney Cancer Symptom Index (FKSI- DRS) questionnaire

Source: https://euclinicaltrials.eu/ctis-public/view/2024-514479-16-00